EU clinical trial 2023-503349-71-00: TransNiDeG - The Effect of Transcutaneous Nicotine Administration on the Development of Delayed Gastric Emptying following Pancreatoduodenectomy - a randomized, placebo-controlled, double-blind, multicenter trial
Protocol code: CHI-202002
Sponsor: Rheinische Friedrich Wilhelms Universitaet Bonn (Educational Institution). Phase: Therapeutic exploratory (Phase II). Countries: Germany (ongoing, recruiting).
Therapeutic area(s): Diseases [C] - Pathological Conditions, Signs and Symptoms [C23]; Diseases [C] - Digestive System Diseases [C06]
Gender: Female, Male. Age: 18-64 years, 65+ years. Enrolment: 240.
Status: Ongoing, recruiting. Start date (EU): 2023-10-30. Decision date: 2023-08-07. Results received: No. Last updated: 2026-04-01.

Condition(s): Pancreatodudoenectomy
Product: Nicotinell 14 mg / 24-Stunden-Pflaster, Patchinga Freestyle Libre 3 Patch

Primary endpoint: Grade of delayed gastric empyting (none, grades A-C representing increasing severity) according to the definition of the International study Group of Pancreatic Surgery
Endpoint(s): postoperative pancreatic fistula, postpancreatectomy hemorrhage, intraabdominal fluid collections, surgical site infections, re-intervention rate, re-operation rate, Clavien-Dindo classification, MTL30 score, quality-of-life questionnaires (QLQ-C30 and PAN26), mortality, cardiovascular events ((non-fatal) myocardial infarction, (non-fatal) stroke, revascularization during admission), requirement of naso-gastric tube (NGT) in the first 21 days after surgery, inability to tolerate solid oral food in the first 21 days after surgery, vomiting/gastric distension in the first 21 days after surgery, use of prokinetics in the first 21 days after surgery, Adverse Events and Serious Adverse Events

Source: https://euclinicaltrials.eu/ctis-public/view/2023-503349-71-00